EU clinical trial 2025-523602-33-00: ROSETTA HCC-206: An Open-Label, Multi-Center, Randomized Phase 1/2 Study of Pumitamig Alone or In Combination with Ipilimumab in Participants with First-Line Advanced or Unresectable Hepatocellular Carcinoma (HCC)
Protocol code: CA2660006
Sponsor: Bristol-Myers Squibb Services Unlimited Company (Pharmaceutical company). Phase: Phase I and Phase II (Integrated)- Other. Countries: Poland (authorised, recruitment pending), Spain (ongoing, recruiting), Germany (ongoing, recruiting), France (ongoing, recruiting), Italy (authorised, recruiting).
Therapeutic area(s): Diseases [C] - Neoplasms [C04]
Gender: Female, Male. Age: 18-64 years, 65+ years. Enrolment: 47.
Start date (EU): 2026-05-13. Decision date: 2026-04-22. Results received: No. Last updated: 2026-04-30.
Decision dates by country: ES: 2026-04-24, PL: 2026-04-23, DE: 2026-04-25, FR: 2026-04-27, IT: 2026-04-30

Condition(s): Advanced or unresectable Hepatocellular Carcinoma (HCC)
Product: BNT327 50 mg ml, BNT327 20 mg ml, IPILIMUMAB, ATEZOLIZUMAB, ATEZOLIZUMAB, BEVACIZUMAB, Ipilimumab

Primary endpoint: The main goal of phase 1 will check and count for how many people have problems or serious problems from the medicine, if anyone must stop taking it because of these problems, and if any problems cause death., The main goal of phase 2 will be to check and count how many people's liver cancer gets much smaller or completely goes away with the treatment (OR (Objective Response) confirmed CR (complete response) or PR (partial response)).
Endpoint(s): To check how many people’s liver cancer gets much smaller or goes away (cancer shrinkage)., To count how many people have problems or serious problems from the medicines, including those who stop treatment or die because of them (safety), To measure how much pumitamig is in the blood after treatment and before the next dose (pumitamig levels)., To measure how much ipilimumab is in the blood before the next dose (ipilimumab levels)., To see if people’s bodies make fighters against the medicines (anti-drug antibodies)., To see how long people live without the cancer getting worse, and how long the cancer stays smaller or goes away (progression delay (PFS, Progression-Free Survival and duration (DOR, Duration of Response).

Source: https://euclinicaltrials.eu/ctis-public/view/2025-523602-33-00